EU clinical trial 2025-525058-20-00: CLARITHROMYCIN TO PREVENT SECONDARY INFECTIONS IN PATIENTS WITH SEPSIS FOLLOWING LOWER RESPIRATORY TRACT INFECTIONS: THE CLASSIFY TRIAL
Protocol code: CLASSIFY
Sponsor: Elliniko Institouto Meletis Tis Sipsis (Laboratory/Research/Testing facility). Phase: Therapeutic confirmatory (Phase III). Countries: Greece (authorised, recruitment pending).
Therapeutic area(s): Diseases [C] - Respiratory Tract Diseases [C08]
Gender: Female, Male. Age: 18-64 years, 65+ years. Enrolment: 252.
Status: Authorised, recruitment pending. Decision date: 2026-06-29. Results received: No. Last updated: 2026-06-29.

Condition(s): Community- acquired pneumonia related sepsis with evidence of Sepsis Induced Immunoparalysis SII
Product: KLARICID® 500 mg/vial Κόνις για πυκνό σκεύασμα για παρασκευή διαλύματος προς έγχυση, Placebo for Clarithromycin film coated tablets 500mg, KLARICID® 500 mg επικαλυμμένα με λεπτό υμένιο δισκία, ΥΔΩΡ ΕΝΕΣΙΜΟ/DEMO, ΔΕΞΤΡΟΖΗ ΕΝΕΣΙΜΟ ΔΙΑΛΥΜΑ / DEMO, διάλυμα για ενδοφλέβια έγχυση 5%

Primary endpoint: The impact of intravenous or oral clarithromycin as adjunctive treatment to SoC antibiotic therapy compared to placebo on the incidence of new infection. This is a composite endpoint incorporating any of the following, Worsening of the episode of CAP for which the patient is enrolled in the study. “Worsening” is defined as need to change SoC during the first 7 days of the study. Change of the SoC to moxifloxacin because of detection of atypical pathogens is not considered worsening of the episode of CAP., Any recurrence of the symptoms of the episode of CAP under study despite improvement after the first 7 days. “Recurrence of symptoms” is defined at the discretion of the attending physician and necessitates the start of new treatment or change of administered treatment after 7 days., Any new infection of any other site than the lung during the first 28 days from inclusion in the study, Any episode of secondary sepsis between day 8 (stop of the study drug) and day 28 of follow-up. This outcome is defined as either onset of any new infection or recrudescence of the episode of CAP under study accompanied by at least 2-point increase of the total SOFA-1 compared to the SOFA-1 score before the onset of the new infection or the recurrence of CAP under study.
Endpoint(s): All-cause 28-day mortality, All-cause 90-day mortality, Sepsis response: this is defined as at least 25% decrease of the day 1 (pre-treatment) SOFA-1 score by day 7, Type of new sepsis episode (predominant pathogen and site of infection), Each of the elements of the composite primary endpoint separately, Time to antimicrobial escalation (days)., Need for hospital re-admission by day 90, Analysis of all secondary endpoints for the subgroup of patients defined by each appropriate treatment pathway., Comparison of outcomes between patients who receive IV clarithromycin., Patient status self-report documented by the EQ-5D questionnaire or a bespoke visual-analog scale., Incremental cost-effectiveness ratios (ICERs) will be calculated and cross-referenced to patients’ health status for both treatment assignments., Biomarkers of sepsis-induced immunosuppression through serial measurement of IFNγ, absolute number of HLA-DR receptors, TNFα by ex-vivo stimulation analysis, serum lipids, ferritin, sTREM-1, sTNFR-1, IL-6, IL-8, protein C and PAI-1.

Source: https://euclinicaltrials.eu/ctis-public/view/2025-525058-20-00